EU clinical trial 2023-510219-20-00: GSDIa Disease Monitoring Program
Protocol code: DTX401-CL401
Sponsor: Ultragenyx Pharmaceutical Inc. (Pharmaceutical company). Phase: Phase III and phase IV (Integrated). Countries: Netherlands (ongoing, recruiting), Spain (ongoing, recruiting), Denmark (ongoing, recruiting), Germany (ongoing, recruiting), Italy (ongoing, recruiting).
Therapeutic area(s): Diseases [C] - Nutritional and Metabolic Diseases [C18]
Gender: Female, Male. Age: 0-17 years, 18-64 years, 65+ years. Enrolment: 14.
Status: Ongoing, recruiting. Start date (EU): 2024-11-04. Decision date: 2024-09-16. Results received: No. Last updated: 2026-02-09.
Decision dates by country: NL: 2024-09-25, DE: 2025-02-25, ES: 2024-09-16, IT: 2025-03-10, DK: 2025-03-19

Condition(s): Glycogen storage disease type Ia (GSDIa)
Product: Pariglasgene brecaparvovec

Primary endpoint: Incidence and severity of SAEs assessed as related to DTX401 by the Investigator, Incidence, relationship, severity, and seriousness of AESIs for AAV therapies (vector-induced hepatic effects [eg, increased aminotransferase levels], malignancy [new or worsening of pre-existing malignancies], thrombotic microangiopathy, dorsal root ganglion/peripheral nerve effects, and any new potential risks of AAV therapies identified over time), Incidence and outcomes of pregnancy in patients treated with DTX401 or patient’s partner, Incidence and severity of SAEs of infusion-related reactions including hypersensitivitya, Incidence and severity of SAEs assessed by the Investigator as related to concomitant immunomodulatory therapies (eg, steroids) including adrenal insufficiency and iatrogenic Cushing’s syndromea
Endpoint(s): Nutritional Assessment;Clinical/CGM/Laboratory/Imaging; Major Clinical Events (MCEs); Patient Experience Clinical Interview; HEOR:

Source: https://euclinicaltrials.eu/ctis-public/view/2023-510219-20-00